EU clinical trial 2025-524205-32-00: First-in-Human Trial to Assess REGN20423 in Healthy Adult Participants and Adult Participants with Atopic Dermatitis
Protocol code: R20423-HV-2555
Sponsor: Regeneron Pharmaceuticals Inc. (Pharmaceutical company). Phase: Human Pharmacology (Phase I)- First administration to humans. Countries: Belgium (ongoing, recruiting).
Therapeutic area(s): Diseases [C] - Skin and Connective Tissue Diseases [C17]
Gender: Female, Male. Age: 18-64 years. Enrolment: 64.
Status: Ongoing, recruiting. Start date (EU): 2026-05-22. Decision date: 2026-04-30. Results received: No. Last updated: 2026-07-08.

Condition(s): Atopic Dermatits

Source: https://euclinicaltrials.eu/ctis-public/view/2025-524205-32-00